EU clinical trial 2022-503028-29-01: Radiation during Osimertinib Treatment: a Safety and Efficacy Cohort Study (ROSE)
Protocol code: AIO-YMO/TRK-0120
Sponsor: AIO-Studien-gGmbH (Laboratory/Research/Testing facility). Phase: Therapeutic exploratory (Phase II). Countries: Germany (ongoing, recruitment ended).
Therapeutic area(s): Diseases [C] - Neoplasms [C04]
Gender: Female, Male. Age: 18-64 years, 65+ years. Enrolment: 40.
Status: Ongoing, recruitment ended. Start date (EU): 2021-12-14. Decision date: 2024-06-21. Results received: No. Last updated: 2026-04-16.

Condition(s): Patients with stage IV EGFR-mutation positive NSCLC target population will comprise 3 parallel cohorts: 1. Irradiation of bone, solid organ (non-lung, non-brain) or soft-tissue metastases; 2. Irradiation of brain metastases (initial lesion size < 3 cm); 3. Irradiation of lung lesions (primary tumor or pulmonary metastases, lesion size < 5 cm)
Product: TAGRISSO 80 mg film-coated tablets

Primary endpoint: Safety and tolerability (Frequency, time of onset and severity of Adverse Events, grading according to CTCAE V5.0), including pneumonitis, interstitial lung disease, radiation pneumonitis, radionecrosis, radiation alveolitis, radiation fibrosis - lung, pulmonary radiation injury and cardiac failure (congestive heart failure - CHF) as adverse events of special interest., Pneumonitis. A consensus definition of pneumonitis based on symptoms, clinical examination, imaging and pulmonary function testing, as well as any available bronchoscopy results, will be used. In the absence of bronchoscopy, pharyngeal wash should be used to exclude viral infections. Care should be taken to differentiate between drug-induced and radiation-induced pneumonitis, by taking into account the localization and time of onset relative to treatment, Radionecrosis: A consensus definition of radionecrosis based on imaging and clinical consultation will be used
Endpoint(s): Progression-free survival (PFS), calculated as PFS1, PFS2, PFS3, PFS0 to assess osimertinib treatment continued beyond several progression events entailing radiotherapy, and prior to first radiotherapy, Time to treatment failure (TTF), Local tumor control, Overall survival (OS), Quality of Life assessed by EORTC QLQ-C30, Optional tumor tissue analysis (pre-study FFPE sample) and biomarker correlation with patient baseline characteristics and outcomes, Target volume of irradiation, Type of irradiation (conventional, stereotactic)

Source: https://euclinicaltrials.eu/ctis-public/view/2022-503028-29-01